EU clinical trial 2024-513511-27-00: ¨Neoadjuvant phase II study of pembrolizumab and carboplatin plus paclitaxel for stage I triple-negative breast cancer (The TELESCOPE study)¨.
Protocol code: MEDOPP599
Sponsor: Medica Scientia Innovation Research S.L. (Pharmaceutical company). Phase: Therapeutic exploratory (Phase II). Countries: Spain (ended).
Therapeutic area(s): Diseases [C] - Neoplasms [C04]
Gender: Female, Male. Age: 18-64 years, 65+ years. Enrolment: 30.
Status: Ended. Start date (EU): 2025-05-29. End date (EU): 2026-07-07. Decision date: 2025-04-08. Results received: No. Last updated: 2026-05-25.

Condition(s): HR-negative/HER2-negative resectable stage I TNBC.
Product: KEYTRUDA 25 mg/mL concentrate for solution for infusion, Paclitaxel Teva 6 mg/ml concentrado para solución para perfusión EFG, Carboplatino Teva 10 mg/ml Concentrado para solución para perfusión

Primary endpoint: The efficacy will be evaluated by pCR rates concerning breast and lymph nodes (pCRBREAST+LYMPH NODE) in the overall population. pCR is defined as the absence of invasive carcinoma in both breast and lymph node tissue following completion of neoadjuvant treatment. The pCR rate will be calculated as the number of responders divided by the number of patients in the analysis set per 100.
Endpoint(s): pCR rates will be calculated concerning breast and lymph nodes (pCRBREAST+LYMPH NODE) in patients with PD-L1 (+) tumors., RCB score and BCS rate in the overall population at surgery, Incidence, severity, and relationship of treatment-emergent adverse events (TEAEs) based on local Investigator assessment as per NCI-CTCAE v5.0.

Source: https://euclinicaltrials.eu/ctis-public/view/2024-513511-27-00